EU clinical trial 2024-518753-42-00: Randomized, double-blind, parallel-groups, active - and placebo-controlled study to Evaluate the efficacy of a fixed combination of diclofenac 75 mg + thiocolchicoside 4 mg as solution for injection, in reLIEving back pain symptoms. Controlled study vs. dicloFenac 75 mg solution for injection and placebo. RELIEF Study
Protocol code: EPDICTIO75+4F01-2022
Sponsor: Epifarma S.r.l. (Pharmaceutical company). Phase: Therapeutic confirmatory (Phase III). Countries: Italy (ended), Greece (ended).
Therapeutic area(s): Diseases [C] - Musculoskeletal Diseases [C05]
Gender: Female, Male. Age: 18-64 years, 65+ years. Enrolment: 216.
Status: Ended. Start date (EU): 2023-03-30. End date (EU): 2025-06-10. Decision date: 2024-11-22. Results received: Yes. Last updated: 2025-06-12.
Decision dates by country: IT: 2024-11-22, GR: 2025-01-23

Condition(s): Low back pain (LBP). LBP is one of the most frequent and disabling health problems. It is estimated that about 80% of adults will experience an episode of acute or chronic LBP at least once during their lifetime The mechanism underlying acute LBP may be disk-, muscle- or posterior articulation related. The aim of the treatment is always to obtain early and maximum relief of the local and regional pain, as well as to improve mobility and physical function.
Product: WATER FOR INJECTION, VOLTAREN 75mg/3mL solution for injection., DICLOFENAC, Diclofenac Sodium 75 mg + Thiocolchicoside 4 mg/ 4 ml solution for injection for intramuscular use

Primary endpoint: Primary efficacy endpoint is the sum of pain intensity difference-SPID, from baseline to Day3 (4 measurements every 12hours, 2 morning/2 evening) in VAS for pain score at rest. Pain intensity difference-PID from baseline is calculated for each of the 4 measurements performed up to Day3 (2 measurements in the morning/2 in the evening) by subtracting each pain intensity-PI score from the baseline PI score. The overall SPID is calculated for the evaluation of the primary efficacy endpoint.
Endpoint(s): Key secondary efficacy endpoint Changes from baseline to Day 3 and Day 7 of muscle contracture (Schober index)., SPID vs. baseline based on morning and evening daily measurements of VAS for pain at all the other daily time points, up to 7 days from the start of treatment, i.e. 5 days after the 2nd i.m. injection., Proportion of responder patients after 48 hours (Day 3) and 7 days (Day 7) from the start of treatment. A responder is defined as a decrease of VAS for pain = 50% vs. baseline (Day 1, pre-administration). Patients who will intake rescue medication within 48 hours from the start of treatment will be considered as non-responder., Changes from baseline to Day 3 and Day 7 of disability due to LBP, as measured using the 24-item Roland Morris disability questionnaire., Use of rescue medication (diclofenac 50 mg tablet): number and percentage of users, number of days with use and number of used tablets, up to Day 3 and up to Day 7., Time elapsed from date/hour of first study drug administration to first intake of the rescue medication., Safety endpoints • Frequency of adverse events and frequency of discontinuation of treatment due to adverse events • Changes from baseline of safety laboratory parameters; • Electrocardiogram (ECG); • Changes from baseline of vital signs (sitting heart rate, systolic/diastolic blood pressure, respiratory rate, body temperature); • Changes from baseline of findings at clinical examination.

Source: https://euclinicaltrials.eu/ctis-public/view/2024-518753-42-00